EU clinical trial 2024-515982-32-00: A Clinical Trial of Tirzepatide (LY3298176) in Subjects With Overweight or Obesity and PCOS-related Ovarian Dysfunction (PERIODS)
Protocol code: MED1-202202
Sponsor: Rheinische Friedrich-Wilhelms-Universitaet Bonn (Educational Institution). Phase: Therapeutic use (Phase IV). Countries: Germany (ongoing, recruiting).
Therapeutic area(s): Diseases [C] - Hormonal diseases [C19]; Diseases [C] - Nutritional and Metabolic Diseases [C18]; Diseases [C] - Female Urogenital Diseases and Pregnancy Complications [C13]
Gender: Female. Age: 18-64 years. Enrolment: 198.
Status: Ongoing, recruiting. Start date (EU): 2025-12-09. Decision date: 2025-07-25. Results received: No. Last updated: 2025-10-06.

Condition(s): Overweight or Obesity, Polycystic Ovary Syndrome (PCOS)
Product: Placebo to match tirzepatide in the doses 2.5, 5, 7.5, 10, 12.5, 15 mg. The placebo is manufactured and incorporated into an auto-injector, packaged and labeled to be identical to tirzepatide. Tirzepatide and placebo will be provided by the original manufacturer Eli Lilly., MEDROXYPROGESTERONE, TIRZEPATIDE, TIRZEPATIDE, DYDROGESTERONE, TIRZEPATIDE, TIRZEPATIDE, TIRZEPATIDE, GLUCOSE, TIRZEPATIDE

Primary endpoint: Mean menstrual bleeding ratio (number of menstrual bleedings divided by treatment period in months) during the last 52 weeks of treatment, assessed at 72 weeks after randomization, Mean change in menstrual bleeding ratio from baseline, calculated at 72 weeks after randomization (with baseline defined as mean menstrual bleeding ratio during the 6 months before randomization)
Endpoint(s): Total number of biochemically confirmed ovulatory events (within 24 weeks after completed dose titration) measured by weekly serum progesterone, Percentage of subjects who achieve a normalization of menstrual cycle (defined as cycle length longer than 21 and less than 35 days or > 8 cycles per year) at 72 weeks after randomization, Serum Anti Müllerian Hormone (AMH), Early follicular total testosterone, estradiol, progesterone, sex hormone-binding globulin (SHBG), DHEA-S and androstenedione, LH and FSH, Calculated free androgen index (FAI) and calculated free testosterone, Mean and percentage change in body weight and % of subjects achieving ≥ 5%, ≥ 10%, ≥ 15%, ≥ 20% of body weight loss from randomization, Mean change in body composition (measured by BIA) from randomization, Mean change in waist circumference (cm) and waist to hip ratio from randomization, Mean change in fasting glucose (mg/dl) from randomization, Mean change in HbA1c (%) from randomization, Mean change in systemic insulin sensitivity from randomization derived by fasting and oGTT data: QUICKI, HOMA-IR, Matsuda's Insulin-sensitivity index, Mean change in fasting triglycerides (mg/dl), total and LDL cholesterol (mg/dl), and triglyceride-to-HDL cholesterol ratio from randomization, Mean change in liver enzymes and non-invasive biomarkers, Fatty Liver Index (FLI), FIB4-score, liver stiffness and fat content from randomization, Mean change in SBP (mmHg) and DBP (mmHg) from randomization, Mean change in hs-CRP (mg/l) from randomization, Mean change in test scores from randomization: 36-Item Short Form Survey (SF-36), Patient Global Impression of Severity (PGI-S), European Quality of Life 5 Dimensions 5 Level Version (EQ-5D-5L5L), Polycystic Ovary Syndrome Health-Related Quality of Life Questionnaire (PCOSQ)

Source: https://euclinicaltrials.eu/ctis-public/view/2024-515982-32-00